EU clinical trial 2024-516919-25-00: A multicenter, randomized, double-blind clinical trial evaluating the efficacy and safety of etanercept versus placebo in the treatment of patients with SAPHO syndrome
Protocol code: NIGRIR_003SAPHO
Sponsor: Narodowy Instytut Geriatrii Reumatologii I Rehabilitacji Im Prof. Dr Hab. Med. Eleonory Reicher (Hospital/Clinic/Other health care facility). Phase: Phase II and Phase III (Integrated). Countries: Poland (ongoing, recruiting).
Therapeutic area(s): Diseases [C] - Immune System Diseases [C20]
Gender: Female, Male. Age: 18-64 years, 65+ years. Enrolment: 60.
Status: Ongoing, recruiting. Start date (EU): 2024-10-22. Decision date: 2024-10-31. Results received: No. Last updated: 2026-04-20.

Condition(s): SAPHO syndrome (synovitis, acne, pustulosis, hyperostosis, osteitis) is a rare disease in which arthritis and osteitis is accompanied by skin lesions such as pustular psoriasis or acne. SAPHO syndrome significantly reduces the quality of life of patients due to the chronic occurrence of pain, limiting the daily activity of patients. About half of patients present also with symptoms of severe axial spondyloarthritis. It can also lead to local bone destruction (usually sternoclavicular joints).
Product: Enbrel 50 mg solution for injection in pre-filled syringe, Enbrel 50 mg solution for injection in pre-filled syringe, Enbrel 25 mg powder and solvent for solution for injection, Enbrel 25 mg powder and solvent for solution for injection, Enbrel 50 mg solution for injection in pre-filled syringe, Enbrel 25 mg powder and solvent for solution for injection, WATER FOR INJECTIONS

Primary endpoint: Improvement in the scope of disease activity as assessed by the patient - a decrease in the overall disease activity as assessed by the patient on the VAS scale by min. 50% after 12 weeks and a decrease in pain assessed by the patient on the VAS scale by min. 50% after 12 weeks

Source: https://euclinicaltrials.eu/ctis-public/view/2024-516919-25-00